EU clinical trial 2025-520837-22-00: A Danish, double-blind, randomized placebo-controlled clinical trial evaluating allogeneic adipose tissue derived mesenchymal stromal cell therapy in patients with recently diagnosed non-ischemic heart failure with reduced ejection fraction.
Sponsor: Cell2Cure ApS (Pharmaceutical company). Phase: Therapeutic exploratory (Phase II). Countries: Denmark (ended).
Therapeutic area(s): Diseases [C] - Cardiovascular Diseases [C14]; Phenomena and Processes [G] - Immune system processes [G12]; Analytical, Diagnostic and Therapeutic Techniques and Equipment [E] - Investigative Techniques [E05]
Gender: Female, Male. Age: 18-64 years, 65+ years. Enrolment: 90.
Status: Ended. End date (EU): 2026-03-27. Decision date: 2025-12-08. Results received: No. Last updated: 2026-01-30.
Decision dates by country: DK: 2026-01-30

Condition(s): Non-ischemic heart failure with reduced ejection fraction
Product: C2C_ASC110, CryoStor® CS10 is used as placebo. CryoStor® CS10 is a freezing medium for cells that contains DMSO. It has been used for cryopreservation of C2C_ASC110 and within the formulation of C2C_ASC110 formulation as excipient. It is serum-free, animal component-free product. It is manufactured according to cGMP principles. It is formulated with USP-grade components to minimize variability and contains 10% DMSO. CryoStor® 10 has been used as an excipient for cryopreservation of the EU marketed product Yescarta® EU/1/18/1299/001, a genetically modifies autologous cell-based product containing transduced T cells (0,4 -2x10^8 cells) for treatment of blood cancers. The product is also approved by US FDA and Health Canada. Thus, CryoStor® is not regarded as a novel excipient. A further description of CryoStor® CS10 are approachable in the IMPD of C2C_ASC110.

Primary endpoint: The primary efficacy endpoint is change in LVEF 6 months after last C2C_ASC110 infusion compared to the patient group treated with placebo (CryoStor CS10) infusion.
Endpoint(s): The secondary efficacy endpoint are changes in LVESV (left ventricular end-systolic volume), LVEF and LVEDV (left ventricular end-diastolic volume) at 7 and 12 months follow-up., Other secondary efficacy endpoints: changes in; NYHA classification; 6-minute walking test; KCCQ and EQ5D5L questionnaire; additional echocardiographic measures and Pro-BNP, Safety endpoints are: incidence and severity of SARs (serious adverse reactions) and SUSARs (suspected unexpected serious adverse reactions) evaluated at 12 months follow-up

Source: https://euclinicaltrials.eu/ctis-public/view/2025-520837-22-00